EU clinical trial 2025-525053-39-00: An International, Multicenter, Randomized, Double-Blind, Placebo-Controlled Phase III Trial on the Effects of EA-230 on the Length of Hospital Stay Following On-Pump Coronary Artery Bypass Grafting Surgery
Protocol code: EASY BOOST
Sponsor: EBI Anti Sepsis B.V. (Pharmaceutical company). Phase: Therapeutic confirmatory (Phase III). Countries: Belgium (authorised, recruitment pending), Netherlands (authorised, recruitment pending).
Therapeutic area(s): Diseases [C] - Cardiovascular Diseases [C14]
Gender: Female, Male. Age: 18-64 years, 65+ years. Enrolment: 150.
Status: Authorised, recruitment pending. Decision date: 2026-04-29. Results received: No. Last updated: 2026-06-22.
Decision dates by country: BE: 2026-04-29, NL: 2026-04-29

Condition(s): Coronary artery disease
Product: NaCl 29 mg/ml in water for injection, EA-230

Primary endpoint: As measured by the median postoperative duration, from the moment of first incision until the time when a patient is eligible to be discharged from the hospital, compared between treatment arms, according to the definitions provided in Summary Table 4. ICU and Hospital Discharge Criteria.
Endpoint(s): As measured by the median postoperative duration, from the moment of first incision until the time when a patient is eligible to be discharged from the ICU and transferred to the general ward, compared between treatment arms, according to the definitions provided in Summary Table 4. ICU and Hospital Discharge Criteria., As measured by the median postoperative duration, from the moment of first incision until the time when a patient is actually discharged from the ICU, and discharged from the hospital, respectively, compared between treatment arms., As measured by the median cumulative duration of moderate and severe Single Organ Outcome Measures (SOOMs) according to the European Perioperative Clinical Outcome (EPCO) definitions during the trial compared between treatment arms., As measured by: A. Median cumulative Net Fluid Balance (NFB) at the start of Investigational Medicinal Product (IMP) administration (T0) and up to 24 and 48 hours thereafter, compared between treatment arms. B. Cumulative dose of vasopressors and inotropes used and vasopressor-inotropic scores up to 0, 24 and 48 hours after IMP administration, compared between treatment arms., As determined by: A. Blood plasma levels of EA-230 measured just before the end of infusion (T4) in all patients. B. Blood plasma levels of EA-230 measured at T0, T0.5, T1, T2, T3 and T4 in a subset of patients ., As measured by the Incidence of treatment-emergent (Serious) Adverse Events ((S)AEs) and Adverse Drug Reactions (ADRs) during the trial period.

Source: https://euclinicaltrials.eu/ctis-public/view/2025-525053-39-00